EU clinical trial 2024-516078-31-00: rEECur: International Randomised Controlled Trial of Chemotherapy for the Treatment of Recurrent and Primary Refractory Ewing Sarcoma
Protocol code: RG_13-277
Sponsor: The University Of Birmingham (Educational Institution). Phase: Phase II and Phase III (Integrated). Countries: Czechia (ongoing, recruiting), Netherlands (ongoing, recruiting), Italy (ongoing, recruiting), Spain (ongoing, recruiting), Denmark (ongoing, recruiting), Finland (ongoing, recruiting), France (ongoing, recruiting), Norway (ongoing, recruiting), Belgium (ongoing, recruiting), Austria (ongoing, recruiting).
Therapeutic area(s): Diseases [C] - Neoplasms [C04]
Gender: Female, Male. Age: 0-17 years, 18-64 years, 65+ years. Enrolment: 436.
Status: Ongoing, recruiting. Start date (EU): 2015-05-05. Decision date: 2024-11-29. Results received: No. Last updated: 2024-12-04.
Decision dates by country: AT: 2024-12-02, BE: 2024-11-29, CZ: 2024-12-03, DK: 2024-11-29, FI: 2024-12-02, FR: 2024-12-02, IT: 2024-12-04, ES: 2024-12-03, NL: 2024-12-04, NO: 2024-11-29

Condition(s): Recurrent and Primary Refractory Ewing Sarcoma
Product: GEMCITABINE, LENVIMA 4 mg hard capsules, TEMOZOLOMIDE, IFOSFAMIDE, ANHYDROUS DOCETAXEL, GEMCITABINE, TEMOZOLOMIDE, CARBOPLATIN, ETOPOSIDE PHOSPHATE, TEMOZOLOMIDE, TEMOZOLOMIDE, DOCETAXEL, IRINOTECAN, LENVIMA 10 mg hard capsules, CYCLOPHOSPHAMIDE, TEMOZOLOMIDE, TOPOTECAN, TEMOZOLOMIDE, ETOPOSIDE

Primary endpoint: Event-free survival time (EFS)
Endpoint(s): Objective imaging response (OR) according to RECIST 1.1 criteria after 2, 4, and 6 cycles for CE and after 2 and 4 cycles for IFOS and IFOS-L, and at the end of trial treatment for all arms, Progression-free survival time (PFS), Overall survival time (OS), Toxicity, defined by National Cancer Institute Common Terminology Criteria for Adverse Events (CTCAE) v4.0 (see Appendix 2 of protocol), PET-CT response after 4 cycles, Quality of life (QoL), Days spent in hospital

Source: https://euclinicaltrials.eu/ctis-public/view/2024-516078-31-00